EU clinical trial 2022-500541-24-00: Comparison of the efficacy of standard treatment associated with phage therapy versus standard treatment plus placebo for diabetic foot ulcers infected by Staphylococcus aureus
Protocol code: PHRC-N/2015/AS-01
Sponsor: Centre Hospitalier Universitaire De Nimes (Hospital/Clinic/Other health care facility). Phase: Phase I and Phase II (Integrated)- Other. Countries: France (authorised, recruiting).
Therapeutic area(s): Diseases [C] - Bacterial Infections and Mycoses [C01]
Gender: Female, Male. Age: 18-64 years, 65+ years. Enrolment: 60.
Status: Authorised, recruiting. Start date (EU): 2024-07-02. Decision date: 2023-09-20. Results received: No. Last updated: 2025-09-29.

Condition(s): Diabetic foot

Source: https://euclinicaltrials.eu/ctis-public/view/2022-500541-24-00